EU clinical trial 2025-521920-31-00: A Randomized, Double-Blind, Placebo-Controlled, Phase 2b Study to Assess the Efficacy, Safety, and Tolerability of IMVT-1402 as Treatment for Adult Patients With Graves' Disease
Protocol code: IMVT-1402-2503
Sponsor: Immunovant Sciences GmbH (Pharmaceutical company). Phase: Therapeutic exploratory (Phase II). Countries: Italy (ongoing, recruiting), Poland (ongoing, recruiting), Greece (ongoing, recruiting), Germany (ended), Netherlands (ongoing, recruiting), Czechia (ongoing, recruiting), Spain (authorised, recruitment pending), Latvia (ongoing, recruiting), Bulgaria (ongoing, recruiting).
Therapeutic area(s): Diseases [C] - Immune System Diseases [C20]
Gender: Female, Male. Age: 18-64 years, 65+ years. Enrolment: 160.
Start date (EU): 2025-11-21. Decision date: 2025-10-17. Results received: No. Last updated: 2026-05-20.
Decision dates by country: CZ: 2025-10-20, LV: 2025-10-20, NL: 2025-10-20, IT: 2025-10-20, PL: 2025-10-21, BG: 2025-10-22, DE: 2025-10-17, ES: 2025-10-20, GR: 2025-10-21

Condition(s): Graves’ Disease
Product: Placebo is identical to IMP but with no active substance., IMVT-1402

Primary endpoint: Proportion of participants who are euthyroid and off ATD at Week 26
Endpoint(s): Proportion of participants who have T3 (Total T3 or FT3) and FT4 ≤ ULN and are off ATD at Week 26, Proportion of participants who are euthyroid, off ATD, and seronegative at Week 26, Proportion of participants who are euthyroid and off ATD at Week 26, Proportion of participants who have T3 (Total T3 or FT3) and FT4 ≤ ULN and are off ATD at Week 26, Proportion of participants who are euthyroid, off ATD, and seronegative at Week 26, Proportion of participants who have T3 (Total T3 or FT3) and FT4 ≤ ULN at Week 4 in participants who have T3 (Total T3 or FT3) and/or FT4 > ULN at baseline, Proportion of participants who have T3 (Total T3 or FT3) and FT4 ≤ ULN at Week 2 in participants who have T3 (Total T3 or FT3) and/or FT4 > ULN at baseline, Proportion of participants who have T3 (Total T3 or FT3) and FT4 ≤ ULN at Week 4 in participants who have T3 (Total T3 or FT3) and/or FT4 > ULN at baseline, Proportion of participants who have T3 (Total T3 or FT3) and FT4 ≤ ULN at Week 2 in participants who have T3 (Total T3 or FT3) and/or FT4 > ULN at baseline

Source: https://euclinicaltrials.eu/ctis-public/view/2025-521920-31-00